EU clinical trial 2025-521519-37-00: A Study Evaluating Monthly (Every 4 Weeks) Dosing of Atacicept in Patients with IgAN
Protocol code: VT-001-0020
Sponsor: Vera Therapeutics Inc. (Pharmaceutical company). Phase: Therapeutic exploratory (Phase II). Countries: Spain (ongoing, recruitment ended), Poland (ongoing, recruitment ended).
Therapeutic area(s): Diseases [C] - Pathological Conditions, Signs and Symptoms [C23]
Gender: Female, Male. Age: 18-64 years, 65+ years. Enrolment: 27.
Status: Ongoing, recruitment ended. Start date (EU): 2025-10-10. Decision date: 2025-09-24. Results received: No. Last updated: 2026-06-16.
Decision dates by country: PL: 2025-09-27, ES: 2025-09-24

Condition(s): IgA Nephropathy (IgAN); Berger Disease; Renal and Urinary Disorders
Product: Atacicept

Primary endpoint: Gd-IgA1 levels through Week 24
Endpoint(s): Incidence of treatment-emergent adverse events, and changes from baseline in routine laboratory and vital sign parameters, IgG, IgM, and IgA levels through Week 24, Serum concentration of atacicept through the end of study, Anti-drug antibody status through the end of study, UPCR values through the end of study

Source: https://euclinicaltrials.eu/ctis-public/view/2025-521519-37-00